EU clinical trial 2024-515167-56-00: DTG/3TC vs BIC/FTC/TAF maintenance therapy in people living with HIV: an open-label randomized clinical trial
Protocol code: GESIDA 11720
Sponsor: Fundacion Seimc Gesida (Laboratory/Research/Testing facility). Phase: Phase III and phase IV (Integrated). Countries: Spain (ended).
Therapeutic area(s): Diseases [C] - Virus Diseases [C02]
Gender: Female, Male. Age: 18-64 years, 65+ years. Enrolment: 555.
Status: Ended. Start date (EU): 2021-06-22. End date (EU): 2025-03-13. Decision date: 2024-09-05. Results received: Yes. Last updated: 2025-06-04.

Condition(s): HIV
Product: Biktarvy 50 mg/200 mg/25 mg film-coated tablets, Dovato 50 mg/300 mg film-coated tablets

Primary endpoint: Proportion of patients with plasma HIV-1 RNA ≥50 copies/mL (FDA Snapshot, 4% non-inferiority margin).

Source: https://euclinicaltrials.eu/ctis-public/view/2024-515167-56-00